EU clinical trial 2022-502642-27-00: RElapse in previously irradiated Prostate bed : a phase I/II study of stereotactic Ablative reIRradiation potentiated by Metformine (REPAIR GETUG P16)
Protocol code: ICO-2020-01 REPAIR
Sponsor: Institut De Cancerologie De L Ouest (Hospital/Clinic/Other health care facility). Phase: Phase I and Phase II (Integrated)- Other. Countries: France (ongoing, recruitment ended).
Therapeutic area(s): Diseases [C] - Neoplasms [C04]
Gender: Male. Age: 18-64 years, 65+ years. Enrolment: 44.
Status: Ongoing, recruitment ended. Start date (EU): 2020-11-26. Decision date: 2024-04-09. Results received: No. Last updated: 2025-10-27.

Condition(s): RElapse in previously irradiated Prostate bed

Source: https://euclinicaltrials.eu/ctis-public/view/2022-502642-27-00